EU clinical trial 2023-504509-36-00: Bioequivalence study of a proposed biosimilar insulin glargine U300 with Toujeo®
Protocol code: GARGN-IJZ-1005
Sponsor: Biocon Sdn. Bhd. (Pharmaceutical company). Phase: Human Pharmacology (Phase I)- Bioequivalence Study. Countries: Germany (ended).
Therapeutic area(s): Diseases [C] - Nutritional and Metabolic Diseases [C18]
Gender: Female, Male. Age: 18-64 years. Enrolment: 68.
Status: Ended. End date (EU): 2024-05-30. Decision date: 2023-06-20. Results received: No. Last updated: 2023-06-20.

Condition(s): Type 1 Diabetes Mellitus

Source: https://euclinicaltrials.eu/ctis-public/view/2023-504509-36-00